EU clinical trial 2024-517611-67-00: Neoadjuvant and postoperative treatment with dabrafenib and trametinib for papillary craniopharyngioma
Protocol code: Swecranio1-21
Sponsor: Region Skane (Hospital/Clinic/Other health care facility). Phase: Therapeutic exploratory (Phase II). Countries: Sweden (ongoing, recruiting).
Therapeutic area(s): Diseases [C] - Neoplasms [C04]; Diseases [C] - Hormonal diseases [C19]
Gender: Female, Male. Age: 18-64 years, 65+ years. Enrolment: 25.
Status: Ongoing, recruiting. Start date (EU): 2024-11-01. Decision date: 2024-10-18. Results received: No. Last updated: 2024-10-18.

Condition(s): papillary craniopharyngioma
Product: TRAMETINIB, DABRAFENIB

Primary endpoint: To evaluate tumour response measured as reduction in tumour volume on MRI for patients with papillary craniopharyngioma on treatment with dabrafenib and trametinib.
Endpoint(s): To evaluate treatment with dabrafenib and trametinib for the following aspects: - response according to RECIST - response duration for patients who are treated without subsequent surgery - number of patients that become operable after neoadjuvant treatment - progression free survival after 1 and 2 years - quality of life during and after treatment - the effect of treatment on vision, cognition and hypothalamic function

Source: https://euclinicaltrials.eu/ctis-public/view/2024-517611-67-00